EU clinical trial 2024-519917-72-00: TRITON-CM: A Phase 3 Global, Randomized, Double-Blind, Placebo-Controlled Study to Evaluate the Efficacy and Safety of Nucresiran in Patients with Transthyretin-Mediated Amyloidosis with Cardiomyopathy (ATTR amyloidosis with cardiomyopathy)
Protocol code: ALN-TTRSC04-003
Sponsor: Alnylam Pharmaceuticals Inc. (Pharmaceutical company). Phase: Therapeutic confirmatory (Phase III). Countries: France (ongoing, recruiting), Germany (ongoing, recruiting), Italy (ongoing, recruiting), Greece (ongoing, recruiting), Belgium (ongoing, recruiting), Portugal (ongoing, recruiting), Netherlands (ongoing, recruiting), Austria (ongoing, recruiting), Sweden (ongoing, recruiting), Denmark (ongoing, recruiting), Spain (ongoing, recruiting), Czechia (ongoing, recruiting), Hungary (ongoing, recruiting), Ireland (authorised, recruiting), Romania (ongoing, recruiting), Norway (ongoing, recruiting), Poland (authorised, recruitment pending), Slovakia (ongoing, recruiting).
Therapeutic area(s): Diseases [C] - Cardiovascular Diseases [C14]
Gender: Female, Male. Age: 18-64 years, 65+ years. Enrolment: 742.
Start date (EU): 2025-10-29. Decision date: 2025-10-14. Results received: No. Last updated: 2026-04-17.
Decision dates by country: AT: 2025-10-20, BE: 2025-10-16, FR: 2025-10-14, DE: 2025-10-14, PT: 2025-10-14, SE: 2025-10-14, IT: 2025-10-16, CZ: 2026-02-06, HU: 2026-01-14, IE: 2026-02-13, PL: 2026-02-16, SK: 2026-02-09, NL: 2025-11-05, ES: 2025-10-15, RO: 2026-02-02, NO: 2026-02-24, DK: 2025-10-14, GR: 2025-10-20

Condition(s): Transthyretin Amyloidosis with Cardiomyopathy (ATTR Amyloidosis with Cardiomyopathy)
Product: Placebo for Nucresiran, ALN-TTRSC04

Primary endpoint: Composite outcome of all-cause mortality and recurrent CV events (CV hospitalizations and urgent HF visits)
Endpoint(s): •Time to first CV event (CV hospitalizations and urgent HF visits) or all-cause mortality •All-cause mortality •Recurrent CV events •Change from baseline in KCCQ-OS

Source: https://euclinicaltrials.eu/ctis-public/view/2024-519917-72-00